EU clinical trial 2024-515978-27-00: Vitamin D as add-on treatment option of pneumonia and sepsis in elderly subjects (TreatViD)
Sponsor: Azienda Ospedaliero-Universitaria Maggiore Della Carita (Hospital/Clinic/Other health care facility). Phase: Phase III and phase IV (Integrated). Countries: Italy (authorised, recruitment pending).
Therapeutic area(s): Diseases [C] - Virus Diseases [C02]; Diseases [C] - Bacterial Infections and Mycoses [C01]; Diseases [C] - Respiratory Tract Diseases [C08]; Analytical, Diagnostic and Therapeutic Techniques and Equipment [E] - Therapeutics [E02]
Gender: Female, Male. Age: 65+ years. Enrolment: 552.
Status: Authorised, recruitment pending. Decision date: 2025-09-10. Results received: No. Last updated: 2025-09-10.

Condition(s): Sepsis, Pneumonia due to a presumed infection
Product: DIBASE 50.000 U.I./2,5 ml soluzione orale in contenitore monodose, Refined olive oil

Primary endpoint: 1) Evaluation of a high dose vitamin D3 regimen effectiveness with respect to placebo in modifying one of the following (whichever occurs first): • Difference in the proportion of patients reaching an in-hospital negative outcome (in-hospital death or ICU admission), within 10 days from admission; • Difference in the proportion of patients reaching an in-hospital positive outcome (discharge or clinical resolution of symptoms (stable NEWS2<2 for at least 24 hours) within 10 days from admission), 2) Evaluation of a high dose vitamin D3 regimen effectiveness with respect to placebo in modifying one of the following: • Difference in the proportion of patient with a 50% reduction of circulating Il-6 within 10 days from admission; • Difference in the proportion of patient with a 50% reduction of circulating C-reactive protein (CRP) within 10 days from admission;
Endpoint(s): Difference in the proportion of patients reaching an in-hospital negative or positive outcome (as previously defined) among patient stratified by age (65-80 years old and ≥80 years old);, Difference in oxygen supplementation and/or mechanical non-invasive ventilation need and its duration (only for patients of the pneumonia section of the study);, Difference in mortality rate at 10, 14, 28 and 90 days;, Difference in hospitalization length (expressed in days);, Difference in plasma vitamin D levels at 2-5-7-10 days (vitamin D quantification data will be extracted from both study-specific blood draws (at 7 and 10 days) and from blood draws performed in order to monitor intervention safety (at 2 and 5 days));, Difference in the proportion of CRP levels reduction below 1 mg/ml at 7 and 10 days;, Difference in inflammatory biomarkers panel (see protocol) at 2-5-7-10 days;, Difference in the proportion of patients reaching an in-hospital negative or positive outcome (as previously defined) among patient stratified by Vitamin D plasma levels at 10 days from admisison (<20 ng/ml and ≥20 ng/ml);, Difference in adverse events and proportion of severe adverse events

Source: https://euclinicaltrials.eu/ctis-public/view/2024-515978-27-00